EU clinical trial 2025-524794-16-00: Efficacy and Safety of Daridorexant in Patients with Major Depressive Disorder (MDD) and Insomnia: Double-blind, randomized, controlled trial
Protocol code: SEDA
Sponsor: Fundacio Institut D'Investigacio Biomedica De Bellvitge IDIBELL (Laboratory/Research/Testing facility). Phase: Therapeutic use (Phase IV). Countries: Spain (authorised, recruitment pending).
Therapeutic area(s): Psychiatry and Psychology [F] - Mental Disorders [F03]
Gender: Female, Male. Age: 18-64 years, 65+ years. Enrolment: 134.
Status: Authorised, recruitment pending. Decision date: 2026-05-04. Results received: No. Last updated: 2026-05-04.

Condition(s): Patients with major depressive episode and moderate to severe insomnia disorder
Product: CELLULOSE, MICROCRYSTALLINE, COLLOIDAL SILICON DIOXIDE, CROSCARMELLOSE SODIUM, MAGNESIUM STEARATE, DARIDOREXANT

Primary endpoint: Improvement in insomnia severity, measured by the Insomnia Severity Index (ISI) at 3 months.
Endpoint(s): To evaluate the efficacy of Daridorexant compared with placebo in improving insomnia as measured by overnight polysomnography at 3 months, including sleep latency, total sleep time, wake after sleep onset., To evaluate the efficacy of Daridorexant compared with placebo in improving depressive symptoms in patients with Major Depressive Disorder (MDD) at 3 months, measured by Montgomery–Åsberg Depression Rating Scale (MADRS), MINI Suicide Module., To evaluate the safety of Daridorexant compared with placebo by monitoring worsening of depressive symptoms, emergence of suicidal ideation at baseline and at 3 months., To compare the side-effect profile of Daridorexant with placebo over the 3-month treatment period., To evaluate the efficacy of Daridorexant compared with placebo in improving quality of life, measured by the EuroQol (EQ-5D) after insomnia treatment at 3 months.

Source: https://euclinicaltrials.eu/ctis-public/view/2025-524794-16-00